EU clinical trial 2024-513836-28-00: A Phase 3, Multicenter, 12-Week, Double Blind, Placebo-Controlled Study to Evaluate the Safety and Efficacy of Atogepant for the Preventive Treatment of Chronic Migraine in Pediatric Subjects 12 to 17 Years of Age
Protocol code: M23-712
Sponsor: AbbVie Deutschland GmbH & Co. KG (Pharmaceutical company). Phase: Therapeutic confirmatory (Phase III). Countries: Poland (ongoing, recruiting), Hungary (ongoing, recruiting), Italy (ongoing, recruiting), Netherlands (ongoing, recruiting), Denmark (ongoing, recruiting), Portugal (ongoing, recruiting).
Therapeutic area(s): Diseases [C] - Nervous System Diseases [C10]
Gender: Female, Male. Age: 0-17 years. Enrolment: 135.
Status: Ongoing, recruiting. Start date (EU): 2025-06-23. Decision date: 2025-05-22. Results received: No. Last updated: 2026-08-05.
Decision dates by country: IT: 2025-05-23, PT: 2026-02-20, NL: 2025-06-25, DK: 2025-05-22, HU: 2025-05-26, PL: 2025-06-01

Condition(s): Chronic Migraine
Product: Placebo for Atogepant, Atogepant

Primary endpoint: Change from Baseline in Mean Monthly Migraine Days Across the 12-Week Treatment Period
Endpoint(s): Change from Baseline in Mean Monthly Headache Days Across the 12-Week Treatment Period, Change from Baseline in Mean Monthly Acute Medication Use Days Across the 12-Week Treatment Period., Percentage of Participants who Achieve at Least a 50% Reduction in 3-Month Average of Monthly Migraine Days., Change from Baseline in the Pediatric Quality of Life Inventory (PedsQL) Total Score at Week 12., Change from Baseline on the Pediatric Migraine Disability Assessment (PedMIDAS) Total Score at Week 12., Change from baseline in mean monthly headache days of at least moderate severity across the 12-week treatment period.

Source: https://euclinicaltrials.eu/ctis-public/view/2024-513836-28-00